EU clinical trial 2024-519278-37-00: A Phase 2, Multicenter, Open-Label Study of CC-97540 (BMS-986353), CD19-Targeted NEX-T CAR T Cells, in Participants with Active SLE (Including Lupus Nephritis) with Inadequate Response to Glucocorticoids and at Least 2 Immunosuppressants (Breakfree-SLE)
Protocol code: CA061-1011
Sponsor: Celgene Corp. (Pharmaceutical company). Phase: Therapeutic exploratory (Phase II). Countries: France (temporarily halted), Spain (temporarily halted), Portugal (temporarily halted), Germany (temporarily halted), Belgium (temporarily halted), Poland (temporarily halted), Italy (temporarily halted), Denmark (temporarily halted), Austria (temporarily halted).
Therapeutic area(s): Diseases [C] - Immune System Diseases [C20]
Gender: Female, Male. Age: 0-17 years, 18-64 years, 65+ years. Enrolment: 35.
Status: Temporarily halted. Start date (EU): 2025-10-22. Decision date: 2025-10-06. Results received: No. Last updated: 2026-04-13.
Decision dates by country: FR: 2025-10-10, AT: 2025-10-16, ES: 2025-10-16, IT: 2025-10-10, DE: 2025-10-16, DK: 2025-10-07, BE: 2025-10-13, PT: 2025-10-16, PL: 2025-10-10

Condition(s): Lupus Nephritis, Systemic Lupus Erythematosus
Product: CD19-Targeted NEX-T CAR T, FLUDARABINE PHOSPHATE, CYCLOPHOSPHAMIDE, TOCILIZUMAB, CYCLOPHOSPHAMIDE, FLUDARABINE, CYCLOPHOSPHAMIDE

Primary endpoint: Proportion of participants achieving drug-free Definition of Remission in Systemic Lupus Erythematosus (DORIS) remission
Endpoint(s): Complete renal response (CRR) for participants with baseline lupus nephritis (LN), Participants with drug-free DORIS remission, CRR for participants with baseline LN, Modified CRR for participants with baseline LN, Number of participants achieving Lupus Low Disease Activity State (LLDAS) with baseline Systemic Lupus Erythematosus Disease Activity Questionnaire (SLEDAI) ≥6, Number of participants achieving SLE Responder Index (SRI) - 4 with baseline SLEDAI ≥6, Number and Severity of participants with flares as assessed by SLEDAI flare index, Change from baseline in proteinuria and estimated glomerular filtration rate (eGFR), Change from baseline in Systemic Lupus International Collaborating Clinics (SLICC) damage, Number and frequency of participants achieving maintenance of drug-free DORIS remission, LLDAS, and SRI-4., Time from first response to loss of response for drug-free DORIS remission, Time from first response to loss of response for LLDAS, and Time from first response to loss of response for SRI-4, Time from baseline to first drug-free DORIS remission, LLDAS, and SRI-4, Duration of drug-free status, Percentage of participants achieving DORIS remission regardless of drug-free status, Cumulative glucocorticoid dose post-infusion used for SLE treatment, Change of serum autoantibodies and complement factors from baseline, Change from baseline in patient reported outcomes (PRO) as assessed by FACIT-Fatigue, SF 36 v2 Acute, EQ-5D-5L, Patient Global Impression of Severity (PGI-S) Pain, and PGI-S Fatigue, Patient Global Impression of Change (PGI-C) Pain and PGI-C Fatigue

Source: https://euclinicaltrials.eu/ctis-public/view/2024-519278-37-00